EU clinical trial 2024-516536-10-00: Combined Pembrolizumab and Lenvatinib after definitive Chemoradiation of locally advanced HNSCC in PD-L1 positive patients (CPS≥1)
Protocol code: PeLeRad
Sponsor: Universitaet Des Saarlandes (Educational Institution). Phase: Therapeutic exploratory (Phase II). Countries: Germany (ongoing, recruitment ended).
Therapeutic area(s): Diseases [C] - Neoplasms [C04]
Gender: Female, Male. Age: 18-64 years, 65+ years. Enrolment: 50.
Status: Ongoing, recruitment ended. Start date (EU): 2023-05-25. Decision date: 2024-09-18. Results received: No. Last updated: 2025-10-06.

Condition(s): Locally advanced head and neck squamous cell carcinoma
Product: LENVIMA 10 mg hard capsules, KEYTRUDA 25 mg/mL concentrate for solution for infusion

Primary endpoint: Event-free survival (EFS) rate at 2 years: The disease progression will be evaluated radiologically (according to RECIST 1.1 criteria, investigator assessed). Death due to any case is an event. In addition, this endpoint will count salvage surgery at any time point for persistent or residual tumor as event if cancer is present in the pathological assessment. Further, neck dissection >20 weeks from the end of RCT will be an event if cancer is present in the pathological assessment

Source: https://euclinicaltrials.eu/ctis-public/view/2024-516536-10-00